EU clinical trial 2023-509095-42-00: Phase II trial of Pembrolizumab and Olaparib in homologous-recombination deficient (HRD) advanced colorectal cancer (CRC).
Protocol code: GEMCAD 2102
Sponsor: Grupo Espanol Multidisciplinar En Cancer Digestivo (Hospital/Clinic/Other health care facility). Phase: Therapeutic exploratory (Phase II). Countries: Spain (ended).
Therapeutic area(s): Diseases [C] - Neoplasms [C04]
Gender: Female, Male. Age: 18-64 years, 65+ years. Enrolment: 40.
Status: Ended. Start date (EU): 2022-07-14. End date (EU): 2025-11-10. Decision date: 2024-07-03. Results received: No. Last updated: 2025-08-06.

Condition(s): Colorectal cancer
Product: Olaparib, Olaparib, KEYTRUDA 25 mg/mL concentrate for solution for infusion

Primary endpoint: Objective response rate.
Endpoint(s): Disease Control Rate., PFS., OS., Duration of response.

Source: https://euclinicaltrials.eu/ctis-public/view/2023-509095-42-00